EU clinical trial 2023-505811-18-00: I4V-MC-JAHW: An Open-label, Active-Controlled, Safety, and Efficacy Study of Oral Baricitinib in Patients From 2 Years to Less Than 18 Years Old With Active Juvenile Idiopathic Arthritis-Associated Uveitis or Chronic Anterior Antinuclear Antibody-Positive Uveitis
Protocol code: I4V-MC-JAHW
Sponsor: Eli Lilly & Co. (Pharmaceutical company). Phase: Therapeutic confirmatory (Phase III). Countries: Italy (ended), Germany (ongoing, recruitment ended), Spain (ongoing, recruitment ended).
Therapeutic area(s): Diseases [C] - Immune System Diseases [C20]
Gender: Female, Male. Age: 0-17 years. Enrolment: 19.
Start date (EU): 2019-11-11. Decision date: 2024-03-04. Results received: No. Last updated: 2026-07-02.
Decision dates by country: IT: 2024-03-11, ES: 2024-06-05, DE: 2024-03-07

Condition(s): Uveitis
Product: BARICITINIB, BARICITINIB, Baricitinib, BARICITINIB, ADALIMUMAB, ADALIMUMAB

Primary endpoint: Response is defined according to the Standardization of Uveitis Nomenclature (SUN) criteria as a 2-step decrease in the level of inflammation (anterior chamber cells) or decrease to zero through week 24, in the eye most severely affected at baseline.

Source: https://euclinicaltrials.eu/ctis-public/view/2023-505811-18-00